EU clinical trial 2023-510057-41-00: Open-Label Extension Phase 3 Study to Evaluate the Long-Term Efficacy and Safety of LIB003 in Patients With Homozygous and Heterozygous Familial Hypercholesterolemia, Cardiovascular Disease, or at High Risk for Cardiovascular Disease, on Stable Lipid-Lowering Therapy Requiring Additional Low-Density Lipoprotein Cholesterol Reduction (LIBerate-OLE)
Protocol code: LIB003-007
Sponsor: Lib Therapeutics LLC (Pharmaceutical company). Phase: Therapeutic confirmatory (Phase III). Countries: Spain (ended), Germany (ended), France (ended), Norway (ended).
Therapeutic area(s): Diseases [C] - Nutritional and Metabolic Diseases [C18]
Gender: Female, Male. Age: 0-17 years, 18-64 years, 65+ years. Enrolment: 590.
Status: Ended. Start date (EU): 2021-10-06. End date (EU): 2025-08-19. End date: 2026-06-10. Decision date: 2024-04-11. Results received: No. Last updated: 2025-04-02.
Decision dates by country: FR: 2024-04-19, DE: 2024-04-15, ES: 2024-04-12, NO: 2024-04-11

Condition(s): Patients With Homozygous and Heterozygous Familial Hypercholesterolemia, Cardiovascular Disease, or at High Risk for Cardiovascular Disease
Product: Lerodalcibep

Primary endpoint: 1. Efficacy. LDL-C change (absolute and percent) compared to original baseline LDL-C at Day 1 in the base study calculated by both Friedewald and Hopkins formulas and preparative ultracentrifugation at Weeks 48 and 72 for patients entering the OLE directly from studies LIB003-004, -005, -006, -008, -011 and -012;, 2. Efficacy. LDL-C change (absolute and percent) compared to original baseline LDL-C at Day 1 in the base study calculated by both Friedewald and Hopkins formulas and preparative ultracentrifugation at Weeks 48 and 72 for patients entering the OLE directly from study LIB003-003;, 3. Efficacy. LDL-C change (absolute and percent) compared to final LDL-C at the last visit of the base study calculated by both Friedewald and Hopkins formulas and preparative ultracentrifugation at Weeks 48 and 72 for only the base study placebo patients entering the OLE directly from studies LIB003-004, -005, -006, and -008;, 4. Efficacy. Effects of LIB003 at Weeks 48 and 72 on serum lipids, including TC, HDL-C, non–HDL-C, VLDL-C, and TG;, 5. Efficacy. Effects of LIB003 at Weeks 48 and 72 on apo B and Lp(a) serum concentrations. For patients entering from the LIB003-011 and -012 studies, effects on apo B and Lp(a) will also be assessed at Week 12 compared to Week 12 or Day 270 of the base studies, respectively;, 6. Efficacy. Effects of LIB003 at Weeks 48 and 72 on serum unbound (free) PCSK9 concentration; and, 7. Efficacy. The percentage of patients achieving current ESC/EAS guidelines., 8. Immunogenicity. Anti-LIB003 antibodies will be initially measured at Week 72/Early Termination [ET]. Other visits including Weeks 12, 24, 36, 48, and 60 will be measured in response to ADAs at Week 72/ET or as indicated by the Data Safety Monitoring Board (DSMB)., 9. Pharmacokinetic. The PK concentration for LIB003 will be measured at Week 72/ET in support of ADAs. Other visits including Weeks 12, 24, 36, 48, and 60 will be measured in response to ADAs at Week 72/ET or as indicated by the DSMB., 10. Safety. Safety endpoints are AEs, including CVEs and all-cause mortality; safety laboratory parameters, with particular attention to hepatic (eg, alanine transaminase [ALT]/aspartate transaminase [AST], bilirubin, alkaline phosphatase) and skeletal muscle (ie, creatine kinase [CK]) toxicities; 12-lead ECGs; ISRs; physical examinations; and vital signs.

Source: https://euclinicaltrials.eu/ctis-public/view/2023-510057-41-00